EU clinical trial 2024-516007-16-00: French prospective randomised double blind study on aspirin versus placebo in resected colon cancer with PI3K mutation stage III or II high risk (PRODIGE 50 - ASPIK)
Protocol code: PRODIGE 50 - ASPIK
Sponsor: Centre Hospitalier Universitaire Rouen (Hospital/Clinic/Other health care facility). Phase: Therapeutic confirmatory (Phase III). Countries: France (authorised, recruitment pending).
Therapeutic area(s): Diseases [C] - Neoplasms [C04]
Gender: Female, Male. Age: 18-64 years, 65+ years. Enrolment: 264.
Status: Authorised, recruitment pending. Decision date: 2024-09-25. Results received: No. Last updated: 2024-09-25.

Condition(s): Resected colon cancer with PI3K mutation stage III or II high risk
Product: Aspirin® protect 100 mg Magensaftresistente Tablette Acetylsalicylsäure, Placebo for Aspirin Protect (Cellulose powder, starch)

Primary endpoint: Disease free survival at 3 years defined as the time from date of randomisation to date of first local or distant recurrence or second colorectal cancer or death from any cause, whichever occurred first
Endpoint(s): Disease-free survival at 5 years, Overall survival at 5 years, Compliance to aspirin (comptability of containers), Severe bleeding grade 3-4 events and hospitalization according to NCI-CTC grading 4.0, Adverse event reported and graded according to NCI-CTC grading 4.0, Serious Adverse events will also be described, Subgroups analyses regarding mutations (KRAS and BRAF) for DFS and OS

Source: https://euclinicaltrials.eu/ctis-public/view/2024-516007-16-00